EU clinical trial 2024-514345-11-00: CAPTIRALL _ Combination of an Anti-PD1 antibody with Tisagenlecleucel Reinfusion in children, adolescents and young adults with Acute Lymphoblastic Leukemia after loss of persistence
Protocol code: APHP200132
Sponsor: Assistance Publique Hopitaux De Paris (Hospital/Clinic/Other health care facility). Phase: Phase I and Phase II (Integrated)- Other. Countries: France (ongoing, recruitment ended).
Therapeutic area(s): Diseases [C] - Hemic and Lymphatic Diseases [C15]; Diseases [C] - Neoplasms [C04]
Gender: Female, Male. Age: 0-17 years, 18-64 years. Enrolment: 26.
Status: Ongoing, recruitment ended. Start date (EU): 2023-03-15. Decision date: 2024-08-19. Results received: No. Last updated: 2024-08-19.

Condition(s): children, adolescents and young adults with Acute Lymphoblastic Leukemia
Product: OPDIVO 10 mg/mL concentrate for solution for infusion., Kymriah 1.2 x 10^6 – 6 x 10^8 cells dispersion for infusion

Primary endpoint: Safety: absence of Limiting-toxicities between infusion and D28, Efficacy: evaluation at M3 after tisagenlecleucel reinfusion and defined by MRD negative CR AND B cell aplasia
Endpoint(s): • Incidence of B cell aplasia at 6 months, • Increase of B cell aplasia duration compared to the previous one observed after the first infusion of tisagenlecleucel (up to 24 months), • Disease best response, • Complete remission (at M1 M3 M6 M12 after reinfusion), • Minimal residual disease (at M1 M3 M6 M12 after reinfusion), • 1-year OS, • 1-year EFS, • Incidence of Grade 3 adverse up to 2 years events such as - nivolumab-related adverse events: myocarditis, pneumonitis, encephalitis - tisagenlecleucel reinfusion-related events, in particular CRS or ICANs or aGVH, prolonged cytopenias, • Incidence of Grade 3, 4 or 5 nivolumab-related adverse events up to 2 years: gut, liver, endocrine, stomatitis, rash or hematologic toxicity, • Incidence of GVHD up to one year, Long term efficacy: 2-year OS and EFS, To explore the PD1 PDL1 axis and its correlation with success or failure

Source: https://euclinicaltrials.eu/ctis-public/view/2024-514345-11-00